EU clinical trial 2024-518164-12-00: ICONICplus - Randomized, double-blind, placebo-controlled trial to investigate the Effects of Cannabidiol plus Naltrexone on Cue-Induced Alcohol Craving in Alcohol Dependence
Protocol code: ICONICplus
Sponsor: Zentralinstitut Fuer Seelische Gesundheit (Hospital/Clinic/Other health care facility). Phase: Therapeutic exploratory (Phase II). Countries: Germany (ongoing, recruiting).
Therapeutic area(s): Psychiatry and Psychology [F] - Mental Disorders [F03]
Gender: Female, Male. Age: 18-64 years, 65+ years. Enrolment: 150.
Status: Ongoing, recruiting. Start date (EU): 2025-06-16. Decision date: 2025-04-28. Results received: No. Last updated: 2026-03-02.

Condition(s): Alcohol dependence
Product: Cannabidiol Placebo Capsules, Cannabidiol Capsules

Primary endpoint: Difference of alcohol craving (Obsessive Compulsive Drinking Scale, OCDS-G) between baseline (visit 2, day -2) and end of treatment (visit 5, day 14)
Endpoint(s): difference from baseline (visit 2, day -2) of OCDS-G craving scores to visits 4 (day 7), 6 (day 28), 7 (day 42), 8 (day 105), 9 (day 196);, difference from baseline of Quality of life (WHO-QOL-BREF scores) to visits 5 (day 14), 6 (day 28), 7 (day 42), 8 (day 105), 9 (day 196);, difference from baseline of depressive symptoms (BDI-II scores) to visit 5 (day 14)., difference from baseline of state and trait anxiety (STAI scores) to visit 5 (day 14)., patient reported outcomes (set of items) at visit 3 (day 1), 4 (day 7), 5 (day 14), 6 (day 28), 7 (day 42), 8 (day 105), 9 (day 196));, CBD plasma levels [visit 3 (day1) and 5 (day14)] (only for patients at CIMH site), time to relapse, cumulative alcohol use and percent heavy drinking days [visit 5 (day 14), 6 (day 28), 7 (day 42), 8 (day 105), 9 (day 196)], Average weekly alcohol consumption and maximum weekly craving assessed every 7th day during the follow up period, starting after visit 5 (day 14) and continuing until visit 9 (day 196) (optional, only for patients that agree to use the study-specific app), differences of neural brain activation during presentation of alcohol cues, natural reward cues, presentation of emotional faces and neutral shapes, during inhibition of motor responses and during resting state from baseline (visit 2, day -2) to visit 5 (day 14) (only for patients at CIMH site), differences of alcohol craving (visual analogue scale), response times, rates of errors, rates of correct responses and omission rates during the fMRI paradigms from baseline (visit 2, day -2) to visit 5 (day 14) (only for patients at CIMH site)

Source: https://euclinicaltrials.eu/ctis-public/view/2024-518164-12-00